EU clinical trial 2024-515583-32-00: A Phase 1/2 Study to Evaluate the Safety, Tolerability, and Efficacy of VX-264 in Subjects With Type 1 Diabetes Mellitus
Protocol code: VX22-264-101
Sponsor: Vertex Pharmaceuticals Inc. (Pharmaceutical company). Phase: Phase I and Phase II (Integrated)- First administration to humans. Countries: Netherlands (ongoing, recruitment ended), Germany (ongoing, recruitment ended), Italy (ongoing, recruitment ended).
Therapeutic area(s): Diseases [C] - Nutritional and Metabolic Diseases [C18]
Gender: Female, Male. Age: 18-64 years, 65+ years. Enrolment: 4.
Status: Ongoing, recruitment ended. Start date (EU): 2023-07-06. Decision date: 2024-09-20. Results received: No. Last updated: 2025-09-18.
Decision dates by country: NL: 2024-09-20, IT: 2024-10-02, DE: 2024-09-25

Condition(s): Type 1 Diabetes Mellitus
Product: VX-264 Implant

Primary endpoint: Part A: Safety and tolerability based on TEAEs (including incidence and severity of AEs and SAEs), ADEs (including SADEs and device deficiencies), clinical laboratory assessments, vital signs, standard 12-lead ECGs, imaging assessments (ultrasound and magnetic resonance imaging), retinopathy evaluation, number of subjects receiving less than the target number of VX 264 units due to AEs, number of subjects with VX 264 units explanted due to AEs or ADEs and/or unit integrity issues., Part B: Safety and tolerability based on TEAEs (including incidence and severity of AEs and SAEs), ADEs (including SADEs and device deficiencies), clinical laboratory assessments, vital signs, standard 12- lead ECGs, imaging assessments (ultrasound and magnetic resonance imaging), retinopathy evaluation, number of subjects receiving less than the target number of VX 264 units due to AEs or ADEs, number of subjects with VX 264 units explanted due to AEs and/or unit integrity issues., Part C: Change from baseline in peak C-peptide during MMTT at Day 90.

Source: https://euclinicaltrials.eu/ctis-public/view/2024-515583-32-00